EU clinical trial 2023-510262-27-00: Randomized controlled multicenter study comparing steroid therapy plus anticoagulants to steroid therapy alone in deep venous thrombosis of Behçet’s syndrome. AntiCoagulation in Treatment Of thRombosis in Behçet's syndrome (ACTOR).
Protocol code: APHP220673
Sponsor: Assistance Publique Hopitaux De Paris (Hospital/Clinic/Other health care facility). Phase: Therapeutic exploratory (Phase II). Countries: France (ongoing, recruiting).
Therapeutic area(s): Diseases [C] - Immune System Diseases [C20]
Gender: Female, Male. Age: 18-64 years, 65+ years. Enrolment: 134.
Status: Ongoing, recruiting. Start date (EU): 2025-06-24. Decision date: 2024-11-12. Results received: No. Last updated: 2025-03-06.

Condition(s): newly diagnosed or relapsing deep venous thrombosis related to Behçet’s syndrome
Product: RIVAROXABAN, RIVAROXABAN

Primary endpoint: Rate of success defined as absence of deep venous thrombosis relapse and major bleeding event, without introduction of additional immunosuppressive medication for BS venous activity at 6 months and following the glucocorticoids tapering.
Endpoint(s): Cumulative incidence of deep venous thrombosis and superficial venous thrombosis relapse within 12 months from randomization, Cumulative incidence of major venous thrombosis (i.e other than limbs) relapse within 12 months from randomization, Cumulative incidence of venous repermeabilization, assessed by vascular imaging at 6 months. The following ultrasound criteria will be used to determine the absence of repermeabilization flow: partial compressibility of the vein, diminution of the vessel diameter, heterogeneous and hyperechoic thrombus, multiple channels of flow inside the veins, reflux, and collateral circulation., Femoral and popliteal vein reflux is defined as retrograde flow > 1 s after calf and thigh compression release while the patient was in the standing position, Measures of corticosteroid sparing: Proportion of patients with a dose ≤ 5 mg/day of prednisone at 6, and 12 months. (prednisone or equivalent prednisone dose only if prednisone is out of stock in the market). Dose at 3, 6 and 12 months. Cumulative dose at 3, 6, and 12 months, Cumulative incidence of major bleeding event within 12 months from randomization, Cumulative incidence of bleeding event within 12 months from randomization, Adverse events (counts, proportions) at 3, 6, and 12 months, Change in SF-36 quality-of-life at 3, 6, and 12 months, from baseline, Change in Behçet's Disease activity scores BDCAF, BSAS and Physician Global Assessment (PhGA) at 3, 6, and 12 months, Overall Survival and event-free-survival within 12 months from randomization, Proportion of post thrombotic syndrome according to Villalta’s post-thrombotic syndrome scale and mean changes in Villalta’s post-thrombotic syndrome scale at 6, and 12 months, Proportion of remission according to other organs involved at 3, 6, and 12 months, Changes in acute-phase reactants at 1, 3, 6, and 12 months

Source: https://euclinicaltrials.eu/ctis-public/view/2023-510262-27-00